EU clinical trial 2024-514803-33-00: A phase II trial of Atezolizumab plus induction chemotherapy (CT) plus chemo-radiotherapy and Atezolizumab maintenance therapy in non-resectable stage IIIA-IIIB-IIIC non-small cell lung cancer (NSCLC) patients (APOLO)
Sponsor: Fundacion GECP (Patient organisation/association). Phase: Therapeutic exploratory (Phase II). Countries: Spain (ended).
Therapeutic area(s): Diseases [C] - Neoplasms [C04]
Gender: Female, Male. Age: 18-64 years, 65+ years. Enrolment: 51.
Status: Ended. Start date (EU): 2021-06-16. End date (EU): 2025-07-31. Decision date: 2024-07-15. Results received: Yes. Last updated: 2025-01-23.

Condition(s): Non-small cell lung cancer (NSCLC)
Product: Tecentriq 1 200 mg concentrate for solution for infusion

Primary endpoint: To assess the efficacy of the treatment (Atezolizumab + Induction chemotherapy (CT) + CT-Radiotherapy) in terms of the Progression Free Survival (PFS) at 12 months according to Response Evaluation Criteria in Solid Tumors (RECIST) Version 1.1.
Endpoint(s): "1. To evaluate the ORR of the treatment as measured by investigator-assessed overall response rate (ORR) according to RECIST v1.1.", 2. To evaluate the PFS rate at 24 months of the treatment., 3. To evaluate the Overall survival (OS) rate at 12 and 24 months of the treatment., 4. To evaluate the sites of first failure, 5. To evaluate the safety and tolerability of Atezolizumab in combination with chemotherapy and Atezolizumab as maintenance treatment.

Source: https://euclinicaltrials.eu/ctis-public/view/2024-514803-33-00